EU clinical trial 2025-522523-96-00: A First-in-Human Study of KK2223 in Participants with T-cell Non-Hodgkin Lymphoma
Protocol code: 2223-001
Sponsor: Kyowa Kirin Inc. (Pharmaceutical company). Phase: Human Pharmacology (Phase I)- First administration to humans. Countries: Spain (authorised, recruitment pending), Italy (authorised, recruitment pending).
Therapeutic area(s): Diseases [C] - Neoplasms [C04]
Gender: Female, Male. Age: 18-64 years, 65+ years. Enrolment: 34.
Status: Authorised, recruitment pending. Decision date: 2026-04-01. Results received: No. Last updated: 2026-04-06.
Decision dates by country: IT: 2026-04-01, ES: 2026-04-06

Condition(s): T-cell Non-Hodgkin Lymphoma, Cutaneous T-cell lymphoma (CTCL), Peripheral T-cell lymphoma (PTCL)

Source: https://euclinicaltrials.eu/ctis-public/view/2025-522523-96-00